EU clinical trial 2024-512839-70-00: A Study to see how safe is RO7567132 as Single Agent and in Combination with Atezolizumab, how the body gets rid of it and how effective it is in people with Advanced and/or Metastatic Solid Tumors
Protocol code: BP44956
Sponsor: F. Hoffmann-La Roche AG (Pharmaceutical company). Phase: Human Pharmacology (Phase I)- First administration to humans. Countries: Denmark (ongoing, recruitment ended), Belgium (ended), France (ended), Spain (ended).
Therapeutic area(s): Diseases [C] - Neoplasms [C04]
Gender: Female, Male. Age: 18-64 years, 65+ years. Enrolment: 61.
Start date (EU): 2024-08-27. Decision date: 2024-07-24. Results received: No. Last updated: 2026-05-04.
Decision dates by country: FR: 2024-12-09, ES: 2024-10-28, BE: 2024-09-09, DK: 2024-07-25

Condition(s): Advanced and/or Metastatic Solid Tumors

Source: https://euclinicaltrials.eu/ctis-public/view/2024-512839-70-00